EU clinical trial 2023-503528-25-00: A clinical trial in healthy people to look at how the body processes RO7268489 over time and when taken before or after a meal
Protocol code: BP44618
Sponsor: F. Hoffmann-La Roche AG (Pharmaceutical company). Phase: Human Pharmacology (Phase I)- Other. Countries: Netherlands (ended).
Therapeutic area(s): Not possible to specify
Gender: Female, Male. Age: 18-64 years. Enrolment: 36.
Status: Ended. Start date (EU): 2023-06-09. End date (EU): 2024-02-20. End date: 2024-02-21. Decision date: 2023-06-01. Results received: No. Last updated: 2023-09-13.

Condition(s): There is no medical condition being investigated. This is a pharmacokinetic study to be performed in healthy participants

Source: https://euclinicaltrials.eu/ctis-public/view/2023-503528-25-00